EU clinical trial 2026-525747-33-00: Progesterone Luteal Support in Unexplained Infertility Management (PLUIM study)
Protocol code: V0003925
Sponsor: Universitair Medisch Centrum Utrecht (Hospital/Clinic/Other health care facility). Phase: Therapeutic use (Phase IV). Countries: Netherlands (authorised, recruitment pending).
Therapeutic area(s): Phenomena and Processes [G] - Reproductive and Urinary Physiological Phenomena [G08]; Diseases [C] - Female Urogenital Diseases and Pregnancy Complications [C13]
Gender: Female. Age: 18-64 years. Enrolment: 640.
Status: Authorised, recruitment pending. Decision date: 2026-06-30. Results received: No. Last updated: 2026-06-30.

Condition(s): unexplained subfertillity, infertillity
Product: Utrogestan 300 mg soft vaginal capsules, The used placebo in this tial in placebo 300mg soft capsuel, in order to match the corresponding active product. The placebo soft capsule is an oblong, slightly yellow capsule containing a whitich oily solution. The placebo presentation is modelled on the corresponding active presentation for the purposes of blinding the imps. The manufacture and control of the placebo is essentially the same as for the active, but without proesterone drug substance and with appropriately compensating quantitites of some excipients. Manufacturing site of the placebo is the same as the actives (cyndea)

Primary endpoint: Pregnancy occurring within 6 months after randomisation, leading to a live birth.
Endpoint(s): Clinical pregnancy, ongoing pregnancy, biochemical pregnancy loss and miscarriage rates within 6 months after randomisation., Of all achieved (ongoing) pregnancies occurring within 6 months after randomisation the following outcomes are assessed; multiple pregnancy rate, time to pregnancy, pregnancy loss, pregnancy complications, perinatal outcomes, type of delivery and outcomes., Side effects and compliance to therapy assessed during treatment using a medication dairy and a questionnaire, send out 6 months after randomisation., Number of adverse events and serious adverse events, Quality of life assessed at time of randomisation, and 6 and 18 months after randomisation, using the FertiQoL questionnaire., Progression to (MOH)IUI/IVF/ICSI within six months after randomisation., Use of ART and (ongoing) pregnancy achieved after the six-month study period and within 12 months follow up., Budget impact, Cost-effectiveness analyses using live birth rates and costs.

Source: https://euclinicaltrials.eu/ctis-public/view/2026-525747-33-00